EU clinical trial 2022-500177-13-00: A Phase 2, Randomized, Open-Label Study Evaluating the Safety and Efficacy of Magrolimab in Combination With Bevacizumab and FOLFIRI Versus Bevacizumab and FOLFIRI in Previously Treated Advanced Inoperable Metastatic Colorectal Cancer (mCRC)
Protocol code: GS-US-587-6156
Sponsor: Gilead Sciences Inc. (Pharmaceutical company). Phase: Therapeutic exploratory (Phase II). Countries: Germany (ended), Spain (ended), France (ended), Belgium (ended), Italy (ended).
Therapeutic area(s): Diseases [C] - Digestive System Diseases [C06]; Diseases [C] - Neoplasms [C04]
Gender: Female, Male. Age: 18-64 years, 65+ years. Enrolment: 46.
Status: Ended. Start date (EU): 2023-06-02. End date (EU): 2024-06-26. End date: 2024-06-27. Decision date: 2022-08-05. Results received: Yes. Last updated: 2024-04-02.
Decision dates by country: ES: 2022-08-08, DE: 2022-08-09, BE: 2022-08-08, FR: 2022-08-05, IT: 2022-10-19

Condition(s): Metastatic Colorectal Cancer (mCRC)
Product: Avastin 25 mg/ml concentrate for solution for infusion, Magrolimab, CAMPTO 20 mg/mL concentrate for solution for infusion, Calcio levofolinato Teva Generics 175 mg polvere per soluzione per infusione, Fluorouracil 50 mg/ml Solution for Injection or Infusion, Paracetamol 500 mg Film Coated Tablets, Leucovorin-Teva 10 mg/ml Concentrate for Solution for Infusion

Primary endpoint: Safety Run-in Cohort: • Percentage of Participants Experiencing Dose-limiting Toxicities (DLTs) According to the National Cancer Institute (NCI) Common Terminology Criteria for Adverse Events (CTCAE) Version 5.0 [ Time Frame: First dose date up to 28 days ], Safety Run-in Cohort: • Percentage of Participants Experiencing Adverse Events (AEs) According to the NCI-CTCAE Version 5.0 [ Time Frame: First dose date up to 3 years ] • Percentage of Participants Experiencing Laboratory Abnormalities According to NCI-CTCAE Version 5.0 [ Time Frame: First dose date up to 3 years ], Randomized Cohort: • Progression-free Survival (PFS) as Determined by Investigator Assessment Using Response Evaluation Criteria in Solid Tumors (RECIST) Version 1.1 [ Time Frame: Up to 3 years ] PFS is defined as the time from the date of randomization until the earliest date of documented disease progression, or death from any cause, whichever occurs first.

Source: https://euclinicaltrials.eu/ctis-public/view/2022-500177-13-00